EU clinical trial 2024-515835-31-00: Phase I/II safety, tolerability and initial efficacy study of adeno-associated viral vector serotype 9 containing human sulfamidase gene after intracerebroventricular administration to patients with MPSIIIA.
Protocol code: ESTEVE-SANF-201
Sponsor: Esteve Pharmaceuticals S.A. (Pharmaceutical company). Phase: Phase I and Phase II (Integrated)- First administration to humans. Countries: Spain (ended).
Therapeutic area(s): Diseases [C] - Nutritional and Metabolic Diseases [C18]
Gender: Female, Male. Age: 0-17 years. Enrolment: 9.
Status: Ended. Start date (EU): 2018-03-20. End date (EU): 2025-10-02. Decision date: 2024-07-22. Results received: Yes. Last updated: 2024-07-22.

Condition(s): Mucopolysaccharidosis type IIIA (Sanfilippo A syndrome)

Primary endpoint: Physical examination., Adverse events., Blood laboratory tests (haematology and chemistry) and Urinalysis., Inflammatory response assessment in blood., Immune response: interferon gamma ELISPOT, intracellular cytokine staining and lymphocyte proliferation in peripheral blood mononuclear cells, neutralizing antibodies (nAb) to the AAV9 vector in cerebrospinal fluid (CSF) and serum and total antibodies to the AAV9 vector and to the transgene quantified in CSF and serum., ECG., Vital signs., Imaging Assessments: Magnetic Resonance Imaging (MRI) and brain volume, Hepatic Ultrasonography assessing volume and structure.
Endpoint(s): Sulfamidase enzymatic activity quantified in CSF and blood (leukocytes). At very specific time points, an additional determination of Sulfamidase enzymatic activity in cultured skin fibroblasts will be done., Heparan Sulfate (HS) levels quantified in CSF, plasma, and urine., Neurological and physical examination., Neurobehavioural skills assessed by Vineland Adaptive Behaviour Scale., Cognitive, language, social-emotional, motor and adaptive development assessed by Bayley Scales of Infant Development or verbal, performance and full Intelligence Quotients (IQs) assessed by Wechsler Scale of Intelligence., The specific recently developed Sanfilippo Behaviour Rating Scale., Evaluation of quality of life by PedsQL scale., Sleep assessment by Polysomnography and Sleep Disturbance Scale for Children., Brain Auditory Evoked Potentials (BAEP)., Real-time ultrasound elastography of the Achilles tendon.

Source: https://euclinicaltrials.eu/ctis-public/view/2024-515835-31-00